EU clinical trial 2023-508543-42-00: A Phase 1, Dose-Escalating, Randomized, Placebo-Controlled, 4-Part Study to Evaluate the Safety, Tolerability, and Pharmacokinetics of COR-1167 in Healthy Subjects and Subjects with Chronic Heart Failure (CHF)
Protocol code: COR1167-101
Sponsor: Corteria Pharmaceuticals (Pharmaceutical company). Phase: Human Pharmacology (Phase I)- First administration to humans. Countries: Netherlands (ended).
Therapeutic area(s): Diseases [C] - Cardiovascular Diseases [C14]
Gender: Female, Male. Age: 18-64 years, 65+ years. Enrolment: 94.
Status: Ended. Start date (EU): 2024-01-22. End date (EU): 2026-05-01. Decision date: 2024-01-19. Results received: No. Last updated: 2026-03-05.

Condition(s): Chronic heart failure

Source: https://euclinicaltrials.eu/ctis-public/view/2023-508543-42-00